EU clinical trial 2024-515321-29-00: A Phase III, Randomized, Placebo-controlled, Double-blind, Multi-center, International Study of Durvalumab Given Concurrently with Platinum-based Chemoradiation Therapy in Patients with Locally Advanced, Unresectable Non-small Cell Lung Cancer (Stage III) (PACIFIC2)
Protocol code: PACIFIC2/D933KC00001
Sponsor: AstraZeneca AB (Pharmaceutical company). Phase: Therapeutic confirmatory (Phase III). Countries: Poland (ended), Hungary (ended).
Therapeutic area(s): Diseases [C] - Neoplasms [C04]
Gender: Female, Male. Age: 18-64 years, 65+ years. Enrolment: 59.
Status: Ended. Start date (EU): 2018-06-26. End date (EU): 2026-02-17. End date: 2026-03-09. Decision date: 2024-11-20. Results received: No. Last updated: 2025-11-17.
Decision dates by country: HU: 2024-11-20, PL: 2024-11-24

Condition(s): Patients with Locally Advanced, Unresectable Non-small Cell Lung Cancer (Stage III)
Product: INFLIXIMAB, MYCOPHENOLIC ACID, SALINE, ETOPOSIDE, CARBOPLATIN, PEMETREXED, IMFINZI 50 mg/mL concentrate for solution for infusion., CISPLATIN, PACLITAXEL

Primary endpoint: PFS using BICR assessments according to RECIST 1.1
Endpoint(s): OS and OS24 ORR, Rate of CR, DoR, DCR, and TTDM using BICR assessments according to RECIST 1.1 PFS2 as defined by local standard clinical practice Concentration of durvalumab in blood (such as peak and trough concentration, as data allow; sparse sampling) ADA (confirmatory results: positive or negative; titers [ADA neutralizing antibodies will also be assessed]), Presence of ADA for durvalumab (confirmatory results: positive or negative; titers); EORTC QLQ-C30 and QLQ-LC13: Change in symptoms, functioning, and global health status/QoL Safety objective: to assess the safety and tolerability profile of durvalumab + SoC CRT compared with placebo + SoC CRT

Source: https://euclinicaltrials.eu/ctis-public/view/2024-515321-29-00